EU clinical trial 2024-518155-37-00: Randomized, open-label clinical trial (Phase 1) to evaluate safety, tolerability, pharmacokinetics and food effects of a single dose of IM-250 in healthy volunteers
Protocol code: IM-103
Sponsor: Innovative Molecules GmbH (Pharmaceutical company). Phase: Human Pharmacology (Phase I)- Other. Countries: Bulgaria (ended).
Therapeutic area(s): Not possible to specify
Gender: Female, Male. Age: 18-64 years. Enrolment: 24.
Status: Ended. Start date (EU): 2025-02-14. End date (EU): 2025-04-16. Decision date: 2025-02-10. Results received: No. Last updated: 2025-04-07.
Decision dates by country: BG: 2025-04-07

Condition(s): Healthy volunteers

Source: https://euclinicaltrials.eu/ctis-public/view/2024-518155-37-00